EU clinical trial 2024-514912-28-00: ALICE : An integrated Phase II/III randomized study comparing durvalumab and tremelimumab +/- Hepatic ArteriaL Infusion Chemotherapy with GEMOX in hepatocellular Carcinoma with high tumor burdEn
Protocol code: UC-GIG-2406
Sponsor: Unicancer (Hospital/Clinic/Other health care facility). Phase: Phase II and Phase III (Integrated). Countries: France (ongoing, recruiting).
Therapeutic area(s): Diseases [C] - Neoplasms [C04]
Gender: Female, Male. Age: 18-64 years, 65+ years. Enrolment: 196.
Status: Ongoing, recruiting. Start date (EU): 2025-10-22. Decision date: 2025-08-11. Results received: No. Last updated: 2026-04-17.

Condition(s): Patients with hepatocellular carcinoma with high tumor burden.
Product: IMFINZI 50 mg/mL concentrate for solution for infusion., IMJUDO 20 mg/ml concentrate for solution for infusion., IMJUDO 20 mg/ml concentrate for solution for infusion., IMJUDO 20 mg/ml concentrate for solution for infusion., IMFINZI 50 mg/mL concentrate for solution for infusion., IMFINZI 50 mg/mL concentrate for solution for infusion., OXALIPLATIN, GEMCITABINE, IMFINZI 50 mg/mL concentrate for solution for infusion., IMJUDO 20 mg/ml concentrate for solution for infusion.

Primary endpoint: For the Phase II study: Objective Response Rate (ORR), defined as the proportion of patients with Complete Response (CR) or Partial Response (PR) as best response according to RECIST 1.1 by investigator evaluation, within the time frame from randomization to 6-month follow-up., For the Phase III study: Overall survival (OS) defined as the time between randomization and death from any cause. A patient who is alive or lost to follow-up at the time of the analysis will be censored at the date of the last protocol visit actually carried out by the patient.
Endpoint(s): Safety of the combination evaluated by: o Frequency of limiting toxicity (LT) occurring during the combination phase (i.e. the first 12 weeks). A LT is defined as any toxicity related to the experimental drug, that require definitive treatment discontinuation of any of the study intervention (HAIC or Durvalumab or Tremelimumab). o Frequency and severity of treatment-related adverse Events (AEs) as per NCI-CTCAE v5.0, until 30 days after the end of any study treatment., Progression-Free survival (PFS), defined as the time between the date of randomization and the date of first progression or death, whichever occurs first. Progression will be defined according to RECIST v1.1 and mRECIST criteria. A patient who is alive and not progressive at the time of the analysis, or lost to follow-up, will be censored at the date of the last protocol visit actually carried out by the patient., In phase II part: Overall survival (OS) defined as the time between randomization and death from any cause. A patient who is alive or lost to follow-up at the time of the analysis will be censored at the date of the last protocol visit actually carried out by the patient., In phase III part: Objective Response Rate (ORR), defined as the proportion of patients with Complete Response (CR) or Partial Response (PR) as best response according to RECIST 1.1., Quality of life according to EORTC QLQ-C30 and HCC-18, evaluated at baseline (before randomization), and every two months until disease progression or study end.

Source: https://euclinicaltrials.eu/ctis-public/view/2024-514912-28-00